EU clinical trial 2024-511237-35-00: A trial to determine the safety and tolerability of transplanted stem cellderived dopamine neurons to the brains of individuals with Parkinson's Disease.
Protocol code: CCTU0263
Sponsor: Region Skane (Hospital/Clinic/Other health care facility). Phase: Phase I and Phase II (Integrated)- First administration to humans. Countries: Sweden (ongoing, recruitment ended).
Therapeutic area(s): Diseases [C] - Nervous System Diseases [C10]
Gender: Female, Male. Age: 18-64 years, 65+ years. Enrolment: 4.
Status: Ongoing, recruitment ended. Start date (EU): 2022-11-30. Decision date: 2024-12-02. Results received: No. Last updated: 2024-12-02.

Condition(s): Parkinson's disease

Source: https://euclinicaltrials.eu/ctis-public/view/2024-511237-35-00